EU clinical trial 2023-509806-31-00: A Randomized Phase 2 Platform Study to Evaluate Cemiplimab Plus Chemotherapy Versus Cemiplimab Plus Chemotherapy Plus Other Cancer Treatments for the Perioperative Treatment of Patients with Resectable Non-Small Cell Lung Cancer
Protocol code: R2810-ONC-2268
Sponsor: Regeneron Pharmaceuticals Inc. (Pharmaceutical company). Phase: Therapeutic exploratory (Phase II). Countries: Spain (ongoing, recruiting), Germany (ongoing, recruiting), France (ongoing, recruiting).
Therapeutic area(s): Diseases [C] - Neoplasms [C04]
Gender: Female, Male. Age: 18-64 years, 65+ years. Enrolment: 54.
Status: Ongoing, recruiting. Start date (EU): 2025-02-11. Decision date: 2024-10-08. Results received: No. Last updated: 2026-06-17.
Decision dates by country: DE: 2024-10-11, FR: 2024-10-08, ES: 2024-10-08

Condition(s): Non-Small Cell Lung Cancer
Product: Carboplatin Hikma 10 mg/ml Konzentrat zur Herstellung einer Infusionslösung, Pemetrexed Fresenius Kabi 500 mg powder for concentrate for solution for infusion, Cisplatinum Accord, 1 mg/ml, koncentrat do sporządzania roztworu do infuzji., LIBTAYO 350 mg concentrate for solution for infusion., Paclitaxel AqVida 6 mg/ml concentrate for solution for infusion, REGN7075

Primary endpoint: Major pathologic response (MPR) rate as determined by central blinded independent pathology review (BIPR)
Endpoint(s): Pathologic complete response (pCR) rate as determined by central BIPR, Residual viable tumor (RVT) as determined by central BIPR, Median event-free survival (EFS), EFS rate, Objective response rate (ORR), Overall survival (OS), Incidence of treatment-emergent adverse events (TEAEs), Severity of TEAEs, Incidence of TEAEs leading to death, Incidence of TEAEs leading to treatment discontinuation, Incidence of serious adverse events (SAEs), Incidence of adverse events of special interest (AESIs), Incidence of immune-mediated adverse events (imAEs), Incidence of infusion-related reactions (IRRs), Incidence of grade ≥3 laboratory abnormalities, Proportion of delayed surgeries due to TEAEs, Proportion of cancelled surgeries due to TEAEs, Incidence of anti-drug antibodies (ADAs) to cemiplimab over time, Titer of ADAs to cemiplimab over time, Incidence of ADAs to novel anti-cancer agents over time, Titer of ADAs to novel anti-cancer agents over time

Source: https://euclinicaltrials.eu/ctis-public/view/2023-509806-31-00